EU clinical trial 2023-508841-42-00: An open-label, multi-center rollover protocol for continued characterization of safety and tolerability for subjects who have participated in a Novartis-sponsored spartalizumab study as single agent or in combination with other study treatments
Protocol code: CPDR001X2X01B
Sponsor: Novartis Pharma AG (Pharmaceutical company). Phase: Human Pharmacology (Phase I)- Other. Countries: Poland (ongoing, recruitment ended), France (ongoing, recruitment ended), Czechia (ongoing, recruitment ended), Italy (ongoing, recruitment ended), Belgium (ongoing, recruitment ended), Spain (ongoing, recruitment ended), Germany (ongoing, recruitment ended), Hungary (ongoing, recruitment ended).
Therapeutic area(s): Diseases [C] - Neoplasms [C04]
Gender: Female, Male. Age: 18-64 years, 65+ years. Enrolment: 75.
Status: Ongoing, recruitment ended. Start date (EU): 2019-10-30. Decision date: 2024-03-22. Results received: No. Last updated: 2026-04-20.
Decision dates by country: CZ: 2024-03-27, FR: 2024-03-27, PL: 2024-03-28, ES: 2024-04-15, HU: 2024-03-26, DE: 2024-03-22, IT: 2024-03-26, BE: 2024-04-02

Condition(s): Different types of advanced cancer
Product: DABRAFENIB MESYLATE, TMT212, CANAKINUMAB, DKY709, LXH254, TRAMETINIB DIMETHYL SULFOXIDE, NIR178, MCS110, LXH254, INC280, TMT212, PDR001, NIR178, PDR001, NIZ985, TRAMETINIB DIMETHYL SULFOXIDE, LAG525, NIR178, LXH254, DABRAFENIB MESYLATE

Primary endpoint: The primary endpoint is the frequency and nature of adverse events (AEs) and serious adverse events (SAE), as well as subjects with dose interruptions and dose reductions.
Endpoint(s): Number of subjects receiving spartalizumab as single agent or in combination with other study treatments and duration of exposure

Source: https://euclinicaltrials.eu/ctis-public/view/2023-508841-42-00